EU clinical trial 2024-516101-23-00: QUIDOSE. Randomized controlled trial testing the efficacy of hydroxychloroquine combined with low dose corticosteroid therapy in pulmonary sarcoidosis.
Protocol code: APHP191105
Sponsor: Assistance Publique Hopitaux De Paris (Hospital/Clinic/Other health care facility). Phase: Therapeutic confirmatory (Phase III). Countries: France (ongoing, recruiting).
Therapeutic area(s): Diseases [C] - Immune System Diseases [C20]; Diseases [C] - Respiratory Tract Diseases [C08]
Gender: Female, Male. Age: 18-64 years, 65+ years. Enrolment: 170.
Status: Ongoing, recruiting. Start date (EU): 2024-10-28. Decision date: 2024-10-28. Results received: No. Last updated: 2026-08-07.

Condition(s): Sarcoidosis
Product: PREDNISONE, HYDROXYCHLOROQUINE, PREDNISONE

Primary endpoint: The difference in forced vital capacity (FVC) percentage of predicted value between baseline and 6 months
Endpoint(s): General Quality of Life: Short Form 36 item (SF-36) questionnaire, Respiratory Quality of Life: St George's Respiratory Questionnaire (SGRQ), Fatigue: Score Fatigue assessment scale (FAS), Hydroxychloroquine Treatment Side Effects: digestive issues (nausea, vomiting), allergic and skin disorders, ocular effects, Corticosteroid Treatment Side Effects : weight, blood pressure, Cushingoid facies, infection episodes, sleep disorders (Pittsburgh Sleep Quality Index - PSQI), anxiety disorders (Hospital Anxiety and Depression Scale - HADS), fasting blood glucose, HbA1c, lipid profile (total cholesterol, TG, HDL-C, LDL-C), nutritional assessment when done as part of care, Treatment Adherence: GIRERD self-questionnaire, Respiratory Function: Measure of FVC, Forced Expiratory Volume in 1 second (FEV1), Carbon Monoxide Diffusing Capacity (DLCO), oxygen saturation, 6-minute walk test (6MWT). The 3-month follow-up will be aimed at assessing the patient's early respiratory progress, as is done in routine practice, Respiratory Symptoms: Dyspnea scores and scales: mMRC, Baseline and Transition Dyspnea Index (BDI-TDI), Dyspnea-12; Cough and Sputum Assessment Questionnaire (CASA-Q), Activity and flares of thoracic and extrathoracic sarcoidosis : Organ involvement assessed clinically using the Wasog sarcoidosis organ assessment instrument adapted by Bickett et al. (Score form), Response to treatment : disappearance/appearance/worsening/improvement/stability of organ involvement using the extra-Pulmonary physician Organ Severity Tool (ePOST)(11), Sarcoidosis-Disease Activity Index (S-DAI)(12), Use of immunosuppressants or increased corticosteroid dose during the study, Biological activity assessed by serum angiotensin-converting enzyme (ACE) levels, calcium, lymphocyte count in complete blood count

Source: https://euclinicaltrials.eu/ctis-public/view/2024-516101-23-00